EU clinical trial 2025-524028-23-00: A Phase III, Randomized, Open-Label, Multicenter Study Evaluating the Efficacy and Safety of Cevostamab in Combination with Pomalidomide and Dexamethasone Versus Standard of Care in Patients with Multiple Myeloma who Have Received One to Three Prior Lines of Therapy
Protocol code: CO46096
Sponsor: F. Hoffmann-La Roche AG (Pharmaceutical company). Phase: Therapeutic confirmatory (Phase III). Countries: France (authorised, recruitment pending), Germany (authorised, recruitment pending), Italy (authorised, recruiting), Greece (ongoing, recruiting), Denmark (authorised, recruitment pending), Czechia (authorised, recruitment pending), Spain (authorised, recruiting), Poland (authorised, recruiting).
Therapeutic area(s): Diseases [C] - Neoplasms [C04]
Gender: Female, Male. Age: 18-64 years, 65+ years. Enrolment: 133.
Start date (EU): 2026-07-28. Decision date: 2026-07-07. Results received: No. Last updated: 2026-07-23.
Decision dates by country: CZ: 2026-07-08, DK: 2026-07-07, DE: 2026-07-09, GR: 2026-07-07, IT: 2026-07-10, ES: 2026-07-09, PL: 2026-07-13, FR: 2026-07-10

Condition(s): Multiple Myeloma
Product: POMALIDOMIDE, Empliciti 400 mg powder for concentrate for solution for infusion., DEXAMETHASONE, DEXAMETHASONE, POMALIDOMIDE, CARFILZOMIB, DEXAMETHASONE, Cevostamab, POMALIDOMIDE, DARATUMUMAB, CARFILZOMIB, DEXAMETHASONE, Empliciti 300 mg powder for concentrate for solution for infusion., Cevostamab, POMALIDOMIDE

Primary endpoint: MRD-negative CR rate at 9 months measured in bone marrow aspirate by next-generation sequencing (NGS), PFS, defined as the time from randomization to the earliest date of disease progression, based on IRC assessment by IMWG criteria, or death due to any cause, whichever occurs first. For participants who have not progressed and are alive, PFS will be censored at the last disease evaluation.
Endpoint(s): VGPR or better rate, defined as the proportion of participants with best overall response of VGPR or better, based on the IRC assessment per IMWG criteria, OS, defined as the time from randomization to death due to any cause. If the participant is alive or the vital status is unknown, then OS will be censored at the date the participant was last known to be alive., Time to confirmed deteriorationin Disease Symptoms scale, defined as an increase in 16 points or more from baseline followed by a second deterioration at a subsequent assessment, as assessed by the EORTC QLQ-MY20, ORR, defined as the proportion of participants with a stringent complete response (sCR), CR, VGPR, or partial response (PR), CR rate, defined as proportion of participants achieving a CR or sCR, TTR (for participants who achieve a response of PR or better), defined as time from randomization to first achieving a PR or better, TTBR (for participants who achieve a response of PR or better), defined as time from randomization to achieving the deepest response, DOR (for participants who achieve a response of PR or better), defined as the time from the date of first documented response of PR or better until the first date of disease progression or death from any cause, whichever occurs first., PFS by investigator, defined as the time from randomization to the earliest date of disease progression, based on the investigator’s assessment, or death due to any cause, whichever occurs first., PFS2, defined as time from randomization to disease progression based on the investigator’s assessment, or death from any cause after initiation of new antimyeloma therapy, whichever is earlier. If disease progression after initiation of new antimyeloma therapy cannot be measured, a PFS2 event is defined as the date of discontinuation of new antimyeloma therapy or death from any cause, whichever is earlier., Overall MRD-negative CR rate, defined as proportion of participants who achieve CR or better and MRD negativity (10-5 threshold) at any timepoint, Overall MRD-negative rate, defined as proportion of participants who achieve MRD negativity (10-5 threshold) at any timepoint regardless of clinical response, Sustained MRD-negative CR rate (at 6, 12, and 24 months, for participants who achieve MRD-negative CR), defined as the maintenance of MRD negativity confirmed ≥6, ≥12, or ≥24 months since first MRD-negative CR assessment, Incidence and severity of adverse events, with severity determined according to the National Cancer Institute Common Toxicity Criteria for Adverse Events, Version 5.0(NCI CTCAE v5.0)and American Society for Transplantation and Cellular Therapy(ASTCT)Consensus Grading for cytokine release syndrome(CRS)(Lee et al. 2019), immune effector cell-associated (ICANS)(Lee et al. 2019), and hemophagocytic lymphohistiocytosis (HLH)/immune effector cell-associated HLH-like syndrome(IEC-HS)(Hines et al. 2023), Change from baseline in selected vital signs, Change from baseline in selected clinical laboratory test results, Tolerability as assessed by the incidence of dose interruptions, dose reductions, dose intensity, and treatment discontinuation, Presence, frequency of occurrence, severity, and/or degree of interference with daily function of shortness of breath, cough, heart palpitations, rash, dizziness, and nausea assessed by the National Cancer Institute Patient Reported Outcomes Common Terminology Criteria for Adverse Events (NCI PRO-CTCAE), Change from baseline in shortness of breath, cough, heart palpitations, rash, dizziness, and nausea assessed by the NCI PRO-CTCAE, Change from Cycle 1 Day 8 in treatment-related side effect bother as assessed by the Functional Assessment of Cancer Therapy-General, General Population 5 (FACTG GP5), Change from baseline in disease symptoms scale of the EORTC QLQ-MY20, Change from baseline in global health status/quality of life (GHS/QoL) scale of the EORTC QLQ-C30, Time to confirmed deterioration in GHS/QoL, defined as a decrease in 10 points or more from baseline followed by a second deterioration at a subsequent assessment, as assessed by the EORTC QLQ-C30, Change from baseline in fatigue as assessed by the EORTC QLQ-C30, Time to confirmed deterioration in fatigue, defined as an increase in 10 points or more from baseline followed by a second deterioration at a subsequent assessment as assessed by the EORTC QLQ-C30, Proportion of participants experiencing a clinically meaningful improvement in disease symptoms while on treatment, defined as a decrease in 16 points or more from baseline as assessed by the EORTC QLQ-MY20, Proportion of participants experiencing a clinically meaningful improvement in GHS/QoL while on treatment, defined as an increase in 10 points or more from baseline as assessed by the EORTC QLQ-C30, Proportion of participants experiencing a clinically meaningful improvement in fatigue while on treatment, defined as a decrease in 10 points or more from baseline as assessed by the EORTC QLQ-C30, Prevalence of anti-drug antibody (ADA) against cevostamab at baseline and incidence of ADA against cevostamab during the study

Source: https://euclinicaltrials.eu/ctis-public/view/2025-524028-23-00